EU clinical trial 2023-508535-32-00: Effects of Metformin on hepatic venous pressure gradient in patients with cirrhosis and portal hypertension – A randomized placebo-controlled study
Protocol code: APHP230872
Sponsor: Assistance Publique Hopitaux De Paris (Hospital/Clinic/Other health care facility). Phase: Therapeutic exploratory (Phase II). Countries: France (ongoing, recruiting).
Therapeutic area(s): Diseases [C] - Digestive System Diseases [C06]
Gender: Female, Male. Age: 18-64 years, 65+ years. Enrolment: 76.
Status: Ongoing, recruiting. Start date (EU): 2025-03-04. Decision date: 2024-09-04. Results received: No. Last updated: 2025-07-02.

Condition(s): Portal hypertension (PHT) and consequences in complications of cirrhosis
Product: METFORMIN, Placebo 515

Primary endpoint: the hepatic venous pressure gradient (HVPG) after 28 days of treatment, Endpoints of the ancillary study: Changes in systemic haemodynamics and HVPG 30 minutes after a meal consisting of two 200 mL bottles of hypercaloric/hyperprotic Fortimel Energy

Source: https://euclinicaltrials.eu/ctis-public/view/2023-508535-32-00